EU clinical trial 2023-503846-30-00: A Phase 1b/2 Open-Label Study of Samuraciclib in Combination with Elacestrant in Participants with Metastatic or Locally Advanced Hormone-Receptor-Positive and Human Epidermal Growth Factor Receptor 2-Negative Breast Cancer
Protocol code: CT7001_003
Sponsor: Carrick Therapeutics Limited (Pharmaceutical company). Phase: Phase I and Phase II (Integrated)- Other. Countries: France (ended), Spain (ended).
Therapeutic area(s): Diseases [C] - Neoplasms [C04]
Gender: Female, Male. Age: 18-64 years, 65+ years. Enrolment: 48.
Status: Ended. Start date (EU): 2023-10-10. End date (EU): 2026-03-06. Decision date: 2023-09-25. Results received: No. Last updated: 2026-03-25.
Decision dates by country: FR: 2023-09-25, ES: 2023-09-25

Condition(s): Breast Cancer
Product: ORSERDU 86 mg film-coated tablets, CT7001, ORSERDU 345 mg film-coated tablets

Primary endpoint: • Phase 1b (Dose-finding): ): Identification of combination, Phase 2, expansion dose level. Dose- limiting toxicities and type, incidence, severity (as graded by CTCAE v5.0), seriousness, and relationship to study medications of AEs and any laboratory abnormalities, • Phase 2 (Expansion): PFS, defined as the time from enrollment until disease progression or death
Endpoint(s): • Type, incidence, severity (as graded by CTCAE v5.0), seriousness, and relationship to study medications of AEs and any laboratory abnormalities, • Clinical benefit response (CBR) 24 weeks (a complete or partial response, or stable disease (SD) for at least 24 weeks)., • Overall Response Rate (ORR), defined as the proportion of participants with a reduction in tumor burden (PR and/or CR in accordance with RECIST v1.1) of a predefined amount, • Duration of Response (DOR), defined as the time from documentation of tumor response (PR and/or CR) to disease progression., • Best percent change in tumor size., • Plasma concentrations and PK parameters of samuraciclib, • Plasma concentrations and PK parameters of elacestrant, • Correlations between ESR1 and TP53 mutations and efficacy/safety findings in this participant population

Source: https://euclinicaltrials.eu/ctis-public/view/2023-503846-30-00